EU clinical trial 2024-519881-32-00: A Single Arm, Open Label, Phase 1/2 Study to Evaluate the Pharmacokinetics and Safety of Etavopivat in Pediatric Patients with Sickle Cell Disease
Protocol code: 4202-HEM-202
Sponsor: Novo Nordisk A/S (Pharmaceutical company). Phase: Phase I and Phase II (Integrated)- Other. Countries: France (authorised, recruitment pending).
Therapeutic area(s): Diseases [C] - Hemic and Lymphatic Diseases [C15]
Gender: Female, Male. Age: 0-17 years. Enrolment: 9.
Status: Authorised, recruitment pending. Decision date: 2026-02-06. Results received: No. Last updated: 2026-07-20.

Condition(s): Sickle Cell Disease
Product: etavopivat B 10041, etavopivat B 10042

Primary endpoint: • Single-dose: maximum concentration (Cmax), area under the concentration time curve (AUC)0-t, AUC0-inf • Steady-state etavopivat plasma exposure (Cmax,ss, AUCtau,ss, Cavg,ss, Cmin,ss) • Estimated using population PK • Incidence of AEs, SAEs, and AEs related to etavopivat • Number of premature discontinuations, dose interruptions, and dose reductions.
Endpoint(s): • Incidence of AEs, SAEs, and AEs related to etavopivat (extension period) • Number of premature discontinuations, dose interruptions, and dose reductions (extension period), • Hb response rate at Weeks 12 and 24 (increase of > 1 g/dL from baseline) • Change in Hb from baseline at Weeks 12 and 24, Incidence of VOCs during the 24-week primary treatment period o Number of VOCs o Annualized Rate of VOC, Change from baseline in Patient-Reported Outcomes Measurement Information System (PROMIS) Fatigue Scale at Weeks 12 and 24 (between 5 to 18 years of age), Change from baseline in time-averaged mean of the maximum velocity (TAMMV) by transcranial Doppler ultrasonography (TCD) (> 2 years of age)

Source: https://euclinicaltrials.eu/ctis-public/view/2024-519881-32-00